EU clinical trial 2023-504690-21-00: Oxytocine and migraine
Sponsor: Erasmus Universitair Medisch Centrum Rotterdam (Erasmus MC) (Hospital/Clinic/Other health care facility). Phase: Human Pharmacology (Phase I)- Other. Countries: Netherlands (authorised, recruitment pending).
Therapeutic area(s): Phenomena and Processes [G] - Physiological processes [G07]; Diseases [C] - Nervous System Diseases [C10]; Diseases [C] - Hormonal diseases [C19]; Analytical, Diagnostic and Therapeutic Techniques and Equipment [E] - Therapeutics [E02]
Gender: Female. Age: 18-64 years. Enrolment: 30.
Status: Authorised, recruitment pending. Decision date: 2025-07-02. Results received: No. Last updated: 2025-10-22.

Condition(s): This is a study in healthy volunteers. We will study the trigeminovascular system, which is relevant in the pathophysiology of migraine.

Source: https://euclinicaltrials.eu/ctis-public/view/2023-504690-21-00